EU clinical trial 2023-503429-20-00: Study evaluating the Safety and Efficacy of Etentamig (ABBV-383) in Subjects with Light Chain Amyloidosis
Protocol code: M24-209
Sponsor: Abbvie Deutschland GmbH & Co. KG (Pharmaceutical company). Phase: Phase I and Phase II (Integrated)- Bioequivalence Study. Countries: Greece (ongoing, recruitment ended), France (ongoing, recruitment ended), Italy (ongoing, recruitment ended).
Therapeutic area(s): Diseases [C] - Neoplasms [C04]
Gender: Female, Male. Age: 18-64 years, 65+ years. Enrolment: 16.
Status: Ongoing, recruitment ended. Start date (EU): 2024-07-31. Decision date: 2024-05-06. Results received: No. Last updated: 2026-05-20.
Decision dates by country: FR: 2024-05-06, GR: 2024-05-13, IT: 2024-05-08

Condition(s): Light Chain Amyloidosis

Source: https://euclinicaltrials.eu/ctis-public/view/2023-503429-20-00